EU clinical trial 2024-513063-45-00: Randomized, controlled, double-blind, multi-center trial to evaluate the efficacy and safety of an Esflurbiprofen Topical System (EFTS) vs. placebo in the local symptomatic and short-term treatment of pain in ankle sprains.
Protocol code: TK-254RX-0301
Sponsor: Teikoku Seiyaku Co. Ltd. (Pharmaceutical company). Phase: Therapeutic confirmatory (Phase III). Countries: Germany (ended).
Therapeutic area(s): Diseases [C] - Musculoskeletal Diseases [C05]
Gender: Female, Male. Age: 18-64 years. Enrolment: 110.
Status: Ended. Start date (EU): 2025-03-06. End date (EU): 2025-10-30. Decision date: 2024-10-29. Results received: No. Last updated: 2025-09-12.

Condition(s): Acute ankle sprains grade I
Product: PARACETAMOL, Placebo patch that does not contain the active ingredient but is otherwise indistinguishable from the investigational drug Esflurbiprofen Topical System., Esflurbiprofen Topical System (EFTS)

Primary endpoint: Sum of Pain Intensity Difference (SPID), of 100-mm- Visual Analogue Scale (VAS) score on pain-on-movement (POM) over 0-48 hours
Endpoint(s): VAS score on POM at 6 h, before bed time on Day 1, 12, 18, 24, 36, 48, 60, 72, 84, 96, 108, 120, 132, 144, 156, 168 h and related PIDs and SPIDs, VAS score on PAR at 6 h, before bed time on Day 1, 12, 18, 24, 36, 48, 60, 72, 84, 96, 108, 120, 132, 144, 156, 168 h and related PIDs and SPIDs, Time to meaningful/optimal reduction of pain defined as first at least 30% (meaningful) and 50% (optimal) reduction from baseline of VAS on POM, Time to complete resolution of pain-on-movement defined as POM VAS value of 0 mm, Time to complete resolution of pain-at-rest defined as PAR VAS value of 0 mm., Responder rate 1 (defined as the number of patients achieving at least 50% reduction from baseline in the VAS score for POM at 48 hours), Responder rate 2 (defined as the number of patients able to resume training / normal physical activity by 168 hours), Resolution of ankle sprain (defined as the percentage of patients who showed POM=PAR=0 at 168 hours), Global efficacy assessments by physician (GEA, 5-point scale: 0=no response; 1=poor response; 2=fair response; 3=good response; 4=excellent response) at 48, 72 and 168 hours, Global efficacy assessments by patient (GEA, 5-point scale: 0=no response; 1=poor response; 2=fair response; 3=good response; 4=excellent response) at 48, 72 and 168 hours, Use of rescue medication at every visit except Visit 1, AEs and SAEs, Local tolerability (skin damage/reaction according to an 8-point scale) at Visit 6, Adhesive power of the EFTS will be visually assessed and classified by the site staff in a 5-point-score (0=≥ 90% adhered / 1= ≥75% to <90% adhered / 2=≥50% to <75% adhered / 3=>0% to <50% adhered / 4=completely detached) at Visit 2-5 (24 hours after EFTS application)., Adhesive power of the EFTS will be visually assessed and classified by the subject in a 5-point-score (0=≥ 90% adhered / 1= ≥75% to <90% adhered / 2=≥50% to <75% adhered / 3=>0% to <50% adhered / 4=completely detached) at before/after bed time and 24 hours after each EFTS application

Source: https://euclinicaltrials.eu/ctis-public/view/2024-513063-45-00